EU clinical trial 2024-512439-54-01: Ablative STEreotactic RadiOtherapy wIth Durvalumab (MEDI4736). An open label randomized phase II trial with durvalumab following Stereotactic Body radiotherapy (SBRT) in patients with T1-2N0M0 Non-small Cell Lung Cancer (NSCLC)
Sponsor: Vaestra Goetalandsregionen (Hospital/Clinic/Other health care facility). Phase: Therapeutic exploratory (Phase II). Countries: Norway (ongoing, recruitment ended), Finland (ongoing, recruitment ended), Sweden (ongoing, recruitment ended).
Therapeutic area(s): Diseases [C] - Neoplasms [C04]
Gender: Female, Male. Age: 18-64 years, 65+ years. Enrolment: 106.
Status: Ongoing, recruitment ended. Start date (EU): 2024-07-24. Decision date: 2024-07-22. Results received: No. Last updated: 2026-06-01.
Decision dates by country: FI: 2024-07-22, NO: 2024-07-24, SE: 2024-07-22

Condition(s): Non-small cell lung cancer (NSCLC)
Product: IMFINZI 50 mg/mL concentrate for solution for infusion.

Primary endpoint: time to progression (TTP)

Source: https://euclinicaltrials.eu/ctis-public/view/2024-512439-54-01